EU clinical trial 2024-516373-77-00: HYVAPRESS. HYdrocortisone and VAsopressine in Post-RESuscitation Syndrome
Sponsor: Assistance Publique Hopitaux De Paris (Hospital/Clinic/Other health care facility). Phase: Therapeutic confirmatory (Phase III). Countries: France (ongoing, recruitment ended).
Therapeutic area(s): Diseases [C] - Cardiovascular Diseases [C14]
Gender: Female, Male. Age: 18-64 years, 65+ years. Enrolment: 380.
Status: Ongoing, recruitment ended. Start date (EU): 2021-07-18. Decision date: 2024-10-24. Results received: No. Last updated: 2025-04-28.

Condition(s): Adult cardiac arrest patients with sustained ROSC and hemodynamic failure due to post-resuscitation syndrome
Product: SODIUM CHLORIDE, HYDROCORTISONE UPJOHN 100 mg, préparation injectable, Placebo of hydrocortisone 100 mg, Reverpleg 40 U.I./2 ml solution à diluer pour perfusion

Primary endpoint: the good neurological outcome at day-30. This will be evaluated using the Glasgow Outcome Scale (GOS, addendum 18.5.1) dichotomized as follow: good neurological outcome for categories 4 and 5 and poor neurological outcome or death for categories 3, 2 and 1. The GOS will be obtained at day-30 from an in-hospital visit if the patient is still hospitalized or from telephone contact with patients, relatives or general practitioners.
Endpoint(s): Vital status at day-30 Time to day-30 caused by irreversible cardiovascular failure defined as death in pharmacologically uncontrollable hypotension (mean arterial blood pressure <60 mmHg) despite maximal ICU care, or withdrawal of care based on same, as previously defined (Witten L, Resuscitation 2019), Time to day-30 caused by neurological withdrawal of care. Withdrawal of care will be based on expectations of a poor neurological recovery based on most recent guidelines (Sandroni C, ICM 2015)., Time to day-30 by comorbid withdrawal of care. Comorbid withdrawal of care or refusal of lifesustaining therapy based on the expectation of a poor quality of life. This may be related to a preexisting or newly discovered terminal illness or other serious medical condition (e.g. dementia or cancer)., Time to brain death (according to French legislation), Time to recurrent cardiac arrest-Proportion of patients dead from a cause not listed above, Glasgow outcome score –extended at day-30. This score will be evaluated similarly to the primary endpoint, Neuron-specific enolase (NSE) blood level measured 48 and 72 hours after CA, Number of days between inclusion and day-30 without :catecholamines - norepinephrine - AVP - inotropic support, Number of patients alive and free of norepinephrine at day-3, -5 and -7 Number of patients alive and free of AVP at day-3, - 5 and -7, Proportion of patients with new onset of atrial fibrillation at day-30, Left ventricular ejection fraction at day-1, 2, 3 and 7. Left ventricular ejection fraction will be evaluated using echocardiography (either trans-thoracic or trans-esophageal), Number of mechanical ventilation free days at day- 30, Number of renal replacement therapy free days at day-30, KDIGO classification at day-7 and day-30. The day- 30 KDIGO classification will be estimated on the creatinine criteria as theurine criteria will be unlikely available. The estimated glomerular filtration rate will becalculated using the MDRD equation., Proportion of patients with acute coronary syndrome defined according to the international guidelines (2015 ESC guidelines) as to know: the detection of an increase and/or a decrease of cardiac troponin and at least one of the following: (1) symptoms of ischemia, (2) new or presumed new significant ST-T wave changes or left bundle branch block on 12-lead ECG; (3) development of pathological Q waves on ECG, (4) imaging evidence of new or presumed new loss of viable myocardium or regional wall mot, Proportion of patients with mesenteric ischemia at day-30, diagnosed on clinical assessment and a computed tomography angiography or endoscopy, Proportion of patients with clinically diagnosed digital ischemia at day-30, Proportion of patients with central diabetes insipidus at argipressin (AVP) weaning. Central diabetes insipidus is defined by a polyuria (> 50mL/kg/24h) associated with an increased plasmatic osmolality (> 300mOsm/L) and a decreased urinary osmolality (< 300mOsm/L), Proportion of patients with gastro-intestinal bleeding at day-30. Gastrointestinal bleeding will be diagnosed as a clinical gastrointestinal bleeding simultaneously with a drop of blood hemoglobin level, Proportion of patients with hyperglycemia occurrence, defined as the number of episodes of blood glucose level higher than 11mmol/L between inclusion and day- 7, ICU and hospital lengths of stay (in days)

Source: https://euclinicaltrials.eu/ctis-public/view/2024-516373-77-00